EU clinical trial 2024-514413-36-00: A phase 1 study of FluBHPVE6E7 immunotherapy in patients with HPV16-associated oropharyngeal squamous cell carcinoma
Protocol code: BS-03
Sponsor: Bluesky Immunotherapies GmbH (Pharmaceutical company). Phase: Human Pharmacology (Phase I)- Other. Countries: Austria (ongoing, recruiting).
Therapeutic area(s): Diseases [C] - Otorhinolaryngologic Diseases [C09]; Diseases [C] - Virus Diseases [C02]
Gender: Female, Male. Age: 18-64 years, 65+ years. Enrolment: 12.
Status: Ongoing, recruiting. Start date (EU): 2024-04-29. Decision date: 2024-08-12. Results received: No. Last updated: 2026-04-30.

Condition(s): Treatment of human papilloma virus (HPV) associated infections and cancers

Source: https://euclinicaltrials.eu/ctis-public/view/2024-514413-36-00